EU clinical trial 2024-511987-10-00: Multicenter, Open-Label Phase II Trial of Cirtuvivint in Selected Advanced Soft-Tissue Sarcomas
Sponsor: Asociacion Europea Y Latinoamericana SELNET Para La Investigacion En Sarcomas (Patient organisation/association). Phase: Therapeutic exploratory (Phase II). Countries: Spain (ongoing, recruitment ended).
Therapeutic area(s): Diseases [C] - Neoplasms [C04]
Gender: Female, Male. Age: 0-17 years, 18-64 years, 65+ years. Enrolment: 28.
Status: Ongoing, recruitment ended. Start date (EU): 2025-04-07. Decision date: 2025-01-15. Results received: No. Last updated: 2026-05-29.

Condition(s): Selected Advanced Soft-Tissue Sarcomas
Product: Cirtuvivint

Primary endpoint: PFSR-3m (according to central radiology assessment): Efficacy measured by the PFSR at 3 months, which is defined as the percentage of patients who did not experience radiological progression according to RECIST v1.1 or death due to any cause since the date of treatment initiation until month 3 after date of treatment initiation.
Endpoint(s): Safety and tolerability will be assessed by adverse events detected through physical examinations and laboratory tests and graded according to CTCAE v5.0., Overall response rate (ORR) (according to central and local assessment): Efficacy measured by ORR, which is defined as the number of patients with a best overall response (BOR) of complete response (CR) or partial response (PR) divided by the number of response evaluable patients (according to RECIST v1.1)., Quality of life: Assessed by using the EORTC QLQ-C30 questionnaire., Median progression-free survival (mPFS) (according to central radiology assessment): Efficacy measured by mPFS, which is defined as the median of time in months from date of treatment initiation to date of radiological progression according to RECIST v1.1 or to date of death due to any cause, whatever occurs first., Median overall survival (mOS): Efficacy measured by an estimation of mOS, which is defined as the median of time in months from date of treatment initiation to date of death due to any cause. OS will be censored on the last date a patient was known to be alive.

Source: https://euclinicaltrials.eu/ctis-public/view/2024-511987-10-00